EU clinical trial 2023-503422-39-00: A Phase III, Randomized, Double-Blind, Placebo-Controlled Study Evaluating Atezolizumab and Bevacizumab, with and without Tiragolumab, In Patients With Untreated Locally Advanced or Metastatic Hepatocellular Carcinoma
Protocol code: CO44668
Sponsor: F. Hoffmann-La Roche AG (Pharmaceutical company). Phase: Therapeutic confirmatory (Phase III). Countries: Belgium (ended), France (ended), Italy (ended), Germany (ended), Spain (ended), Poland (ended).
Therapeutic area(s): Diseases [C] - Neoplasms [C04]
Gender: Female, Male. Age: 18-64 years, 65+ years. Enrolment: 182.
Status: Ended. Start date (EU): 2023-10-20. End date (EU): 2026-08-03. Decision date: 2023-10-02. Results received: No. Last updated: 2026-04-14.
Decision dates by country: BE: 2023-10-03, FR: 2023-10-02, DE: 2023-10-05, IT: 2023-10-04, ES: 2023-10-05, PL: 2023-10-09

Condition(s): Hepatocellular Carcinoma (HCC)
Product: Avastin 25 mg/ml concentrate for solution for infusion., Tecentriq 1 200 mg concentrate for solution for infusion, Tiragolumab, Placebo Tiragolumab

Primary endpoint: Investigator-assessed PFS, OS
Endpoint(s): Investigator-assessed confirmed ORR, Investigator-assessed DOR, Investigator-assessed PFS rate at 6 and 12 months, OS rate at 1 and 2 years, Investigator-assessed PFS, confirmed ORR, and DOR as determined by the investigator according to HCC mRECIST, TTCD, defined as change from baseline in GHS/QoL, Physical Functioning, and Role Functioning, as assessed through use of the EORTC QLQ-C30, Incidence and severity of adverse events, with severity determined according to National Cancer Institute Common Terminology Criteria for Adverse Events version 5.0 (NCI CTCAE v5.0) grading scale, Severity for cytokine release syndrome (CRS) will also be determined according to the American Society for Transplantation and Cellular Therapy (ASTCT) CRS Consensus Grading scale, Serum concentration of atezolizumab and tiragolumab at specified timepoints, Prevalence of anti-drug antibodies (ADAs) to tiragolumab at baseline and incidence of ADAs to tiragolumab after treatment, Prevalence of ADAs to atezolizumab at baseline and incidence of ADAs to atezolizumab after treatment

Source: https://euclinicaltrials.eu/ctis-public/view/2023-503422-39-00